EU clinical trial 2024-517758-87-00: Pharmacokinetic study of minocycline in patients with nontuberculous mycobacterial disease
Protocol code: Mino-PK
Sponsor: Radboud universitair medisch centrum Stichting (Hospital/Clinic/Other health care facility). Phase: Human Pharmacology (Phase I)- Bioequivalence Study. Countries: Netherlands (ended).
Therapeutic area(s): Analytical, Diagnostic and Therapeutic Techniques and Equipment [E] - Therapeutics [E02]; Diseases [C] - Bacterial Infections and Mycoses [C01]
Gender: Female, Male. Age: 18-64 years, 65+ years. Enrolment: 15.
Status: Ended. Start date (EU): 2023-06-22. End date (EU): 2025-06-11. Decision date: 2024-09-24. Results received: No. Last updated: 2024-09-24.

Condition(s): Nontuberculous mycobacterial disease

Source: https://euclinicaltrials.eu/ctis-public/view/2024-517758-87-00